EU clinical trial 2023-506033-29-00: A Randomized, Open-label Phase 3 Study of Combination Amivantamab and Carboplatin-Pemetrexed Therapy, Compared with Carboplatin-Pemetrexed, in Patients with EGFR Exon 20ins Mutated Locally Advanced or Metastatic Non-Small Cell Lung Cancer
Protocol code: 61186372NSC3001
Sponsor: Janssen - Cilag International (Pharmaceutical company). Phase: Therapeutic confirmatory (Phase III). Countries: Spain (ended), Belgium (ended), France (ended), Germany (ended), Hungary (ended), Portugal (ongoing, recruitment ended), Italy (ongoing, recruitment ended), Poland (ongoing, recruitment ended).
Therapeutic area(s): Diseases [C] - Neoplasms [C04]
Gender: Female, Male. Age: 18-64 years, 65+ years. Enrolment: 64.
Start date (EU): 2020-10-09. Decision date: 2024-02-21. Results received: No. Last updated: 2026-05-20.
Decision dates by country: HU: 2024-02-21, BE: 2024-02-23, DE: 2024-02-23, PT: 2024-02-22, FR: 2024-02-26, PL: 2024-02-23, ES: 2024-02-21, IT: 2024-02-23

Condition(s): EGFR Exon 20ins Mutated Locally Advanced or Metastatic Non-Small Cell Lung Cancer
Product: JNJ-61186372, Carboplatin 10 mg/ml Intravenous Infusion, CARBOPLATIN, Pemetrexed Seacross 500 mg powder for concentrate for solution for infusion, PEMETREXED

Primary endpoint: Progression-Free Survival (PFS) (using RECIST v1.1 guidelines), as assessed by blinded independent central review (BICR)

Source: https://euclinicaltrials.eu/ctis-public/view/2023-506033-29-00